EU clinical trial 2024-515580-64-00: Phase 1b/2 trial of 5-fluorouracil, leucovorin, irinotecan in combination with temozolomide (FLIRT) and bevacizumab for the first-line treatment of patients with MGMT silenced, microsatellite stable metastatic colorectal cancer.
Sponsor: Fondazione IRCCS Istituto Nazionale Dei Tumori (Hospital/Clinic/Other health care facility). Phase: Phase I and Phase II (Integrated)- First administration to humans. Countries: Italy (ongoing, recruiting).
Therapeutic area(s): Diseases [C] - Neoplasms [C04]; Diseases [C] - Digestive System Diseases [C06]
Gender: Female, Male. Age: 18-64 years, 65+ years. Enrolment: 33.
Status: Ongoing, recruiting. Start date (EU): 2020-12-31. Decision date: 2024-08-12. Results received: No. Last updated: 2025-12-22.

Condition(s): metastatic colorectal cancer

Source: https://euclinicaltrials.eu/ctis-public/view/2024-515580-64-00